EU clinical trial 2024-512759-19-00: Evaluation of the early bactericidal activity of tedizolid and linezolide against Mycobacterium tuberculosis (TEDITUB)
Protocol code: APHP210084
Sponsor: Assistance Publique Hopitaux De Paris (Hospital/Clinic/Other health care facility). Phase: Therapeutic exploratory (Phase II). Countries: France (ongoing, recruiting).
Therapeutic area(s): Diseases [C] - Bacterial Infections and Mycoses [C01]
Gender: Female, Male. Age: 18-64 years, 65+ years. Enrolment: 60.
Status: Ongoing, recruiting. Start date (EU): 2023-04-20. Decision date: 2024-08-13. Results received: No. Last updated: 2026-06-26.

Condition(s): first suspected infection with Mycobacterium tuberculosis in the lungs
Product: LINEZOLID, ISONIAZID, RIFAMPICIN, TEDIZOLID PHOSPHATE, ETHAMBUTOL, PYRAZINAMIDE, RIFAMPICIN, PYRAZINAMIDE AND ISONIAZID

Primary endpoint: The measurement will be done as follow: EABD1D3= (log10 number of CFU (CFU= colony forming unit) of M. tuberculosis on medium 7H11/mL of sputum on D1) - (log10number of CFU of M. tuberculosis on medium 7H11/mL of sputum on D3)/2.
Endpoint(s): The measurement will be done as follow: EBAD3D8= (log10 number of CFU (CFU=colony forming unit) of M. tuberculosis on medium 7H11/mL of sputum on D3) - ( log10 number of CFU of M. tuberculosis on medium 7H11/mL of sputum at D8)/5, Compare the early bactericidal activity of tedizolid 200 mg / day to that of linezolid 1200 mg / day between Day 1 and Day 3 and between Day 3 and Day 8, Compare the early bactericidal activity of tedizolid 200 mg / day to that of standard quadruple therapy between Day 1 and Day 3 and between Day 3 and Day 8, ABPJ1J3 of tedizolide measured in terms of time to positivity of cultures in liquid medium called ABPJ1J3L= (time to positivity of culture of sample at D3) - (time to positivity of culture of sample at D1)/2 (i.e. after the first 2 days of treatment with tedizolide), Bactericidal activity in liquid medium between D3 and D8 (ABPJ3J8L) of tédizolide, ABPJ1J3L and ABPJ3J8L of tedizolide compared with linezolide, ABPJ1J3L and ABPJ3J8L of tedizolide compared with standard four-therapy treatment, Total and free concentration of tedizolid measured at 0, 1, 3, 5, and 24h, Area under the curve (AUC), Toxicity of tedizolide assessed at D7 and D30. Adverse events leading to premature discontinuation of treatment

Source: https://euclinicaltrials.eu/ctis-public/view/2024-512759-19-00